EU clinical trial 2025-522404-24-01: Test-Retest Evaluation of [18F]F-AraG in Lung Tumors (TREAT)
Sponsor: Amsterdam UMC Stichting (Patient organisation/association). Phase: Phase II and Phase III (Integrated). Countries: Netherlands (authorised, recruitment pending).
Therapeutic area(s): Diseases [C] - Neoplasms [C04]; Diseases [C] - Respiratory Tract Diseases [C08]
Gender: Female, Male. Age: 18-64 years, 65+ years. Enrolment: 7.
Status: Authorised, recruitment pending. Decision date: 2026-01-27. Results received: No. Last updated: 2026-01-27.

Condition(s): Lung Cancer
Product: NELARABINE

Primary endpoint: The absolute and relative difference in SUV and TBR uptake between both scanning timepoints

Source: https://euclinicaltrials.eu/ctis-public/view/2025-522404-24-01